EU clinical trial 2023-505039-11-00: Basket study for oligo-metastatic breast cancer - ANISE
Sponsor: Stichting Het Nederlands Kanker Instituut-Antoni van Leeuwenhoek Ziekenhuis (Hospital/Clinic/Other health care facility). Phase: Therapeutic exploratory (Phase II). Countries: Netherlands (ongoing, recruiting), France (authorised, recruitment pending), Italy (authorised, recruitment pending), Spain (authorised, recruitment pending), Sweden (authorised, recruitment pending).
Therapeutic area(s): Diseases [C] - Neoplasms [C04]
Gender: Female, Male. Age: 18-64 years, 65+ years. Enrolment: 112.
Start date (EU): 2024-05-02. Decision date: 2023-11-13. Results received: No. Last updated: 2025-11-07.
Decision dates by country: NL: 2023-11-13, FR: 2025-10-03, IT: 2025-11-07, ES: 2025-11-04, SE: 2025-10-30

Condition(s): breast cancer, HER2-positive, oligometastatic disease
Product: DS-8201a

Primary endpoint: Complete radiologic response as defined by RECIST1.1
Endpoint(s): Complete radiologic response as defined by RECIST1.1 along with clearance of ctDNA, PFS as defined by RECIST 1.1., Pathological complete response in patients undergoing resection of primary tumor and/or metastatic lesions after neo-adjuvant treatment, Complete metabolic response as defined by EORTC guidelines, Preplanned loco-regional treatment performed without treatment related delay (window of 3 weeks), Incidence and severity of adverse events (CTCAE v5.0) until 30 days after last treatment administration. Incidence and severity of interstitial lung disease (ILD), Incidence and severity of adverse events grade ≥3 (CTCAE v5.0 or Clavien-Dindo in case of surgical resection) until 30 days after last treatment administration in relation to local therapy

Source: https://euclinicaltrials.eu/ctis-public/view/2023-505039-11-00